EU clinical trial 2023-503435-17-00: A Phase 3, Multicenter, Double-blind, Randomized, Placebo-controlled, Parallel Group Study to Evaluate the Efficacy, Safety and Pharmacokinetics of Apremilast in Children From 5 to Less Than 18 Years of Age With Active Juvenile Psoriatic Arthritis (PEAPOD)
Protocol code: 20190529
Sponsor: Amgen Inc. (Pharmaceutical company). Phase: Therapeutic confirmatory (Phase III). Countries: France (ongoing, recruiting), Portugal (ongoing, recruiting), Belgium (ended), Lithuania (ongoing, recruiting), Germany (ongoing, recruiting), Netherlands (authorised, recruiting), Spain (ongoing, recruiting), Poland (ended), Romania (authorised, recruiting), Italy (ongoing, recruiting), Austria (ongoing, recruitment ended), Greece (ongoing, recruiting).
Therapeutic area(s): Diseases [C] - Immune System Diseases [C20]
Gender: Female, Male. Age: 0-17 years. Enrolment: 51.
Start date (EU): 2021-03-31. Decision date: 2024-03-07. Results received: No. Last updated: 2026-07-13.
Decision dates by country: ES: 2024-03-08, BE: 2024-03-08, PL: 2024-03-12, DE: 2024-03-12, IT: 2024-03-11, FR: 2024-03-11, LT: 2024-04-02, AT: 2024-04-08, PT: 2024-03-07, RO: 2024-03-18, NL: 2024-03-07, GR: 2024-04-09

Condition(s): Juvenile psoriatic arthritis
Product: Apremilast, Apremilast, Apremilast placebo product is supplied to the clinic as 10, 20 and 30 mg tablets and 5 mg/mL oral solution. The placebo product is the same as the drug product formulation except there is no active apremilast., Apremilast, Apremilast

Primary endpoint: Number of participants achieving ACR Pedi 30 from baseline (week 0) to week 16
Endpoint(s): Change in subject's assessment of pain (a), Number of participants achieving ACR Pedi 20/50/70/90 (a), Change in Childhood Heath Assessment Questionnaire (CHAQ) (a), Change in Juvenile Arthritis Disease Activity Score (JADAS) (a), Refer to protocol for fully list of secondary endpoints., PASI-75 response at week 16 for subjects with a baseline psoriasis BSA equal or more than 3% (a), Number of participants who experience PsA flares (a)

Source: https://euclinicaltrials.eu/ctis-public/view/2023-503435-17-00